EU clinical trial 2024-513279-41-00: A Phase 2, Randomized, Double-Blind, Placebo-Controlled, Parallel Group Study to Evaluate the Efficacy and Safety of Once Weekly s.c. Administered GL0034 in Adults with Type 2 Diabetes Mellitus Inadequately controlled on Metformin Or Diet and Exercise
Protocol code: SP-GL0034-02
Sponsor: Sun Pharmaceutical Industries Limited (Pharmaceutical company). Phase: Therapeutic exploratory (Phase II). Countries: Germany (ended).
Therapeutic area(s): Diseases [C] - Nutritional and Metabolic Diseases [C18]
Gender: Female, Male. Age: 18-64 years, 65+ years. Enrolment: 60.
Status: Ended. Start date (EU): 2024-09-06. End date (EU): 2026-04-07. Decision date: 2024-07-26. Results received: No. Last updated: 2025-11-10.

Condition(s): Type 2 diabetes mellitus
Product: GL0034 4 mg/ml, 1 ml per vial, GL0034 3 mg/ml, 1 ml per vial, Same solution as for GL0034 without drug substance; solution for subcutaneous injection; volume identical to dose of test product, GL0034 1mg/ml, 0.6ml per vial, GL0034 1 mg/ml, 1 ml per vial

Primary endpoint: Incidence and severity of gastrointestinal adverse events as assessed by a symptom score, Frequency of gastrointestinal adverse events per participant
Endpoint(s): Change From Baseline in Glycated Hemoglobin (HbA1c), Change from Baseline in Mean Daily Plasma Glucose (PG), Changes in metabolic parameters (e.g. glucagon, C-peptide, insulin), Change from Baseline in body weight and waist circumference, Change from Baseline in lipid profile (TG, TC, HDL, LDL, VLDL), Pharmacokinetics of GL0034, Safety endpoints (e.g. adverse events others than gastrointestinal events, clinical laboratory parameters)

Source: https://euclinicaltrials.eu/ctis-public/view/2024-513279-41-00